EU clinical trial 2024-514117-35-00: Evaluation of the value of perianal infiltration during thermodestruction of hemorrhoidal disease by Radiofrequency (RAFAELO® procedure)
Sponsor: Centre Hospitalier Departemental Vendee (Hospital/Clinic/Other health care facility). Phase: Phase III and phase IV (Integrated). Countries: France (ended).
Therapeutic area(s): Diseases [C] - Digestive System Diseases [C06]; Diseases [C] - Skin and Connective Tissue Diseases [C17]
Gender: Female, Male. Age: 18-64 years, 65+ years. Enrolment: 134.
Status: Ended. Start date (EU): 2023-01-10. End date (EU): 2026-01-15. Decision date: 2024-05-29. Results received: Yes. Last updated: 2025-07-08.

Condition(s): hemorrhoidal disease
Product: ROPIVACAINE, ROPIVACAINE

Primary endpoint: Visual analogue scale (VAS) at H6 post-op (6 hours after the start of the procedure). The H6 criterion was retained, since the duration of efficacy of ropivacaine is 6 to 12 hours. It seemed appropriate to compare the 2 groups in terms of infiltration efficacy, in order to assess whether infiltration was beneficial or not.

Source: https://euclinicaltrials.eu/ctis-public/view/2024-514117-35-00